EU clinical trial 2023-509812-27-01: Evaluation of safety of somatic cell based therapy for urinary incontinence in patients after radical prostatectomy, open trial.
Protocol code: SUICell-T1
Sponsor: Nicolaus Copernicus University (Educational Institution). Phase: Human Pharmacology (Phase I)- First administration to humans. Countries: Poland (authorised, recruitment pending).
Therapeutic area(s): Diseases [C] - Male Urogenital Diseases [C12]
Gender: Male. Age: 18-64 years, 65+ years. Enrolment: 15.
Status: Authorised, recruitment pending. Decision date: 2024-10-31. Results received: No. Last updated: 2026-04-15.

Condition(s): urinary incontinence

Source: https://euclinicaltrials.eu/ctis-public/view/2023-509812-27-01